EU clinical trial 2025-520735-16-00: Electrochemotherapy as a first line treatment in recurrent squamous cell carcinoma of the oral cavity and oropharynx: a randomized controlled trial (ECT-HN)
Sponsor: IRCCS Istituto Nazionale Tumori Fondazione Pascale (Hospital/Clinic/Other health care facility). Phase: Therapeutic exploratory (Phase II). Countries: Italy (ended).
Therapeutic area(s): Diseases [C] - Neoplasms [C04]
Gender: Female, Male. Age: 18-64 years, 65+ years. Enrolment: 96.
Status: Ended. End date (EU): 2025-09-02. Decision date: 2025-01-31. Results received: No. Last updated: 2025-01-31.

Condition(s): CARCINOMA OF THE ORAL CAVITY AND OROPHARYNX
Product: BLEOPRIM 15 mg polvere per soluzione iniettabile, Fluorouracile Teva 250 mg/5 ml soluzione per infusione, CARBOPLATINO TEVA 10 mg/ml concentrato per soluzione per infusione, CETUXIMAB, PEMBROLIZUMAB, Cisplatino Teva Italia 0,5 mg/ml concentrato per soluzione per infusione

Primary endpoint: Superiority of electrochemotherapy treatment with bleomycin in terms of objective response compared to treatment with cetuximab + platinum-based therapy + 5-fluorouracil.
Endpoint(s): Overall survival, Assessment of disease-free progression time between the two groups, Evaluation of the duration of the response intended as the time from the first complete or partial response documentation to the first occurrence of disease or death progression, Assessment of disease control,intended as complete response, partial response and stable disease, between the two groups, Quality of life assessment (EORTC QLQ-C30, EORTC QLQ-H & N35, EQ-5D-5L) with particular attention to the effect on pain and bleeding between the two groups

Source: https://euclinicaltrials.eu/ctis-public/view/2025-520735-16-00